EU clinical trial 2024-512393-10-00: An open label, single arm trial evaluating the efficacy and safety of EVX-01 in combination with pembrolizumab in checkpoint inhibitor treatment naïve adults with unresectable or metastatic melanoma
Protocol code: EVX-01-001
Sponsor: Evaxion A/S (Pharmaceutical company). Phase: Therapeutic exploratory (Phase II). Countries: Italy (ended).
Therapeutic area(s): Diseases [C] - Neoplasms [C04]
Gender: Female, Male. Age: 18-64 years, 65+ years. Enrolment: 3.
Status: Ended. Start date (EU): 2023-03-15. End date (EU): 2025-09-23. Decision date: 2024-06-17. Results received: No. Last updated: 2025-07-25.

Condition(s): unresectable or metastatic melanoma
Product: EVX-01, KEYTRUDA 25 mg/mL concentrate for solution for infusion

Primary endpoint: Composite of a BOR of CR or PR for patients with SD at the time of EVX-01 administration and a BOR of CR for patients with PR at the time of EVX-01 administration, during 24 months of treatment with pembrolizumab, as per RECIST 1.1 criteria.
Endpoint(s): Overall response rate, defined as the proportion of the patients in the analysis population who have best response as CR or PR assessed 24 months after initiation of treatment with pembrolizumab as per RECIST 1.1 criteria, PFS assessed 24 months after initiation of treatment with pembrolizumab and defined as the time from initiation of pembrolizumab treatment to the first documented disease progression per RECIST 1.1. criteria or death due to any causes, whichever occurs first, OS, assessed 24 months after initiation of treatment with pembrolizumab and defined as the time from initiation of treatment of pembrolizumab to death due to any cause, Number, type and severity of AEs and SAEs, Level of immunologic response toward EVX-01 measured by CD4+ and CD8+ neoepitope specific lymphocytes, assessed throughout dosing with EVX-01

Source: https://euclinicaltrials.eu/ctis-public/view/2024-512393-10-00